EU clinical trial 2024-517780-24-00: A Phase III, Randomized, Double-blind, Multicenter, Global Study of Rilvegostomig or Pembrolizumab Monotherapy for the First-line Treatment of Patients with PD-L1-high Metastatic Non-small Cell Lung Cancer (ARTEMIDE-Lung04)
Protocol code: D702GC00001
Sponsor: AstraZeneca AB (Pharmaceutical company). Phase: Therapeutic confirmatory (Phase III). Countries: Romania (ongoing, recruiting), Bulgaria (authorised, recruiting), Ireland (ongoing, recruiting), Portugal (ongoing, recruiting), Greece (ongoing, recruiting), Germany (ongoing, recruiting), Belgium (ongoing, recruiting), France (ongoing, recruiting), Italy (ongoing, recruiting), Spain (ongoing, recruiting).
Therapeutic area(s): Diseases [C] - Neoplasms [C04]
Gender: Female, Male. Age: 18-64 years, 65+ years. Enrolment: 383.
Start date (EU): 2025-09-18. Decision date: 2025-06-12. Results received: No. Last updated: 2026-07-29.
Decision dates by country: IE: 2025-06-13, BE: 2025-06-12, BG: 2025-06-12, PT: 2025-06-16, GR: 2025-06-16, RO: 2025-06-16, DE: 2025-06-13, IT: 2025-11-06, ES: 2025-12-18, FR: 2025-12-22

Condition(s): Lung Cancer
Product: Rilvegostomig, INFLIXIMAB, MYCOPHENOLATE MOFETIL, KEYTRUDA 25 mg/mL concentrate for solution for infusion

Primary endpoint: Overall survival (OS), Progression-free survival (PFS)
Endpoint(s): Landmark overall survival (OS) rates, Landmark progression-free (PFS) rates, Overall response rate (ORR), Duration of response (DoR), Time to second progression or death (PFS2), Concentration of rilvegostomig in serum., Presence ADAs, titer, and neutralizing antibodies for rilvegostomig., Proportion of participants with maintained or improved physical functioning., Time to deterioration (TTD) of global health status (GHS)/quality of life (QoL) and in pulmonary symptoms., Adverse events (AEs) (graded by CTCAE version 5.0), clinical laboratory assessments, vital signs, physical examinations, and Eastern Cooperative Oncology Group (ECOG) performance status.

Source: https://euclinicaltrials.eu/ctis-public/view/2024-517780-24-00